EU clinical trial 2023-503341-60-00: Efficacy evaluation of 188Re-SSS lipiodol Selective Internal Radiation Therapy of non operable hepatocellular carcinoma patients, a phase II study
Protocol code: 2017-1-14-010
Sponsor: Centre De Lutte Contre Le Cancer Eugene Marquis (Hospital/Clinic/Other health care facility). Phase: Therapeutic exploratory (Phase II). Countries: France (ended).
Therapeutic area(s): Diseases [C] - Neoplasms [C04]
Gender: Female, Male. Age: 18-64 years, 65+ years. Enrolment: 35.
Status: Ended. Start date (EU): 2024-02-14. End date (EU): 2026-04-24. Decision date: 2023-07-05. Results received: No. Last updated: 2025-11-06.

Condition(s): non-operable hepatocellular carcinoma
Product: 188Re-SSS Lipiodol

Primary endpoint: The objective response rate, defined as the best overall response occurring within 6 months’ post 188Re-SSS lipiodol injection according to the modified RECIST criteria for hepatocellular carcinoma, The best overall responses at months 1, 3, and every 3 months until 24 months after radioembolization, Time to liver progression (TTLP), defined as the time from patient inclusion to progression according modified RECIST criteria, Progression-free survival (PFS), defined as the time from patient inclusion to progression according mRECIST criteria (whatever the location of the progressive lesion) including death from any cause and initiation of a new antineoplastic therapy, Overall survival (OS), defined as the time from patient inclusion to death from any cause, The biological response rate is defined as the proportion of patients with a complete or partial AFP response, as determined by the lowest serum alpha-fetoprotein (AFP) level observed during the first six months. A complete AFP response is defined as normalization of the AFP level at a minimum of one-point measurement. A partial AFP response is defined as no normalization of the AFP level, but a reduction of at least 20% from the baseline level. Point measurements are planned at M1, M3, and M6

Source: https://euclinicaltrials.eu/ctis-public/view/2023-503341-60-00